EU clinical trial 2024-514377-22-00: Effect of levothyroxine as adjuvant therapy to a hypocaloric diet in the treatment of obesity: a randomized placebo-controlled trial.
Protocol code: LEVOBESITY
Sponsor: Fundacion Publica Andaluza Para La Investigacion De Malaga En Biomedicina Y Salud (Laboratory/Research/Testing facility). Phase: Therapeutic confirmatory (Phase III). Countries: Spain (ongoing, recruiting).
Therapeutic area(s): Diseases [C] - Nutritional and Metabolic Diseases [C18]
Gender: Female, Male. Age: 18-64 years. Enrolment: 286.
Status: Ongoing, recruiting. Start date (EU): 2025-09-04. Decision date: 2024-09-20. Results received: No. Last updated: 2025-07-31.

Condition(s): Metabolic disease
Product: Eutirox 88 microgramos comprimidos, MICROCRYSTALLINE CELLULOSE

Primary endpoint: Weight loss (measured in percentage (%) and kilograms (kg)) and body composition changes (BMI, waist/hip circumference, fat mass, fat free mass, body water by impedance measurement) from baseline to the end of intervention program at 3 months (sample size: 286 subjects).
Endpoint(s): Weight Regain Prevention Rate in patients who previously underwent a weight loss intervention (the same parameters as on the endpoint will be measured) from month three untill the end of the treatment., Changes in the stage of obesity (obesity type I and II) measured by changes in BMI., Changes in cardiovascular risk factors: lipids, blood pressure, glucose, HbA1c, HOMA-IR, adipokines and inflammation markers., Changes in resting energy expenditure determined by indirect calorimetry., Differences in the degree of physical activity quantified by accelerometry., Changes in cardiac function: heart rate, ventricular extrasystoles, QT interval (EKG); and the apparition of side effects and adverse reactions., Changes in metabolic activity of adipose tissue., Gut microbiota analysis, epigenetic studies and analysis of genes related to obesity., Changes in nitrogen balance., Define gender, as a determining factor in reaching the primary endpoint and secondary outcomes., Changes in quality of life (EuroQol-5D quality of life questionnaire).

Source: https://euclinicaltrials.eu/ctis-public/view/2024-514377-22-00